EU clinical trial 2023-504212-15-00: A phase I/IIa, prospective, mono-center, double-blinded, randomized, controlled study to assess the safety and efficacy of applying PLX-PAD cells for the treatment of mild to moderate knee osteoarthritis - PROTO
Sponsor: Charite Universitaetsmedizin Berlin KöR (Hospital/Clinic/Other health care facility). Phase: Phase I and Phase II (Integrated)- Other. Countries: Germany (not authorised).
Therapeutic area(s): Diseases [C] - Musculoskeletal Diseases [C05]
Gender: Female, Male. Age: 18-64 years, 65+ years. Enrolment: 132.
Status: Not authorised. Decision date: 2024-03-06. Results received: No. Last updated: 2024-03-06.

Condition(s): Osteoarthritis
Product: Placebo has the same composition as the tested IMP with the exception of the active substance (PLX-PAD cells); is not authorized; is manufactured by the same manufacturer as IMP PLX-PAD., Cetirizin-ratiopharm® bei Allergien Filmtabletten

Primary endpoint: Evaluation of the safety of the (PLX-PAD) cell treatment by assessing all adverse events, with specific consideration to allergic reactions, local site reactions, joint reactions, and immunosuppression. Adverse events shall be assessed for relatedness, seriousness and severity.
Endpoint(s): Primary Efficacy Endpoint: The potential change of the WOMAC pain score at week 26 compared to the baseline (BL) (visit 1) (0-20, where 0 is no pain)., Assessment of joint synovitis and effusion (MRI) at BL, weeks 26, 52 and 156;, Assessment of cartilage score using magnetic resonance imaging (MRI) location-independent analysis for knee articular cartilage at BL and weeks 52 and 156, Assessment of WOMAC score at BL, weeks 1, 4, 12, 26, 52, 104, and 156, Assessment of the KOOS score at BL, weeks 1, 4, 12, 26, 52, 104, and 156, Assessment of PROMIS-29 standardized QoL measure at BL, weeks 1, 4, 12, 26, 52, and 104, Exploratory Endpoint: evaluation of the use of pain medication at BL, weeks 1, 4, 12, 26, and 52, Exploratory Endpoint: evaluation of the numeric pain rating scale (NPRS) at BL, weeks 1, 4, 12, 26, and 52, Exploratory Endpoint: evaluation of the NPRS after 10 Meter Walk Test at BL, weeks 26 and 52, Exploratory Endpoint: Genetic profile (Whole-genome sequencing, WGS), Exploratory Endpoint: Biomarker analysis in synovial fluid (SF) specimens at BL and week 52, Exploratory Endpoint: Biomarker analysis in blood and urine specimens at BL and weeks 1, 4, 12, 26, and 52, Exploratory Endpoint: Semiquantitative analysis of OA related degenerative alterations in the joint: MRI Osteoarthritis Knee Score (MOAKS) at BL, weeks 26, 52, and 156, Exploratory Endpoint: Potential change from BL for extension strength for the ipsi- and contralateral knee at weeks 26 and 52, Exploratory Endpoint: Functional 3D-gait analysis at BL and weeks 26 and 52, Exploratory Endpoint:

Source: https://euclinicaltrials.eu/ctis-public/view/2023-504212-15-00